EU clinical trial 2023-509254-58-00: A global multicenter phase 1/2 trial of EO2463, a novel microbial-derived peptide therapeutic vaccine, as monotherapy, and in combination with lenalidomide and rituximab, for treatment of patients with indolent Non-Hodgkin's Lymphoma.
Protocol code: EONHL1-20
Sponsor: Enterome (Pharmaceutical company). Phase: Phase I and Phase II (Integrated)- First administration to humans. Countries: Spain (ongoing, recruiting), Italy (ongoing, recruiting), France (ongoing, recruiting).
Therapeutic area(s): Diseases [C] - Neoplasms [C04]
Gender: Female, Male. Age: 18-64 years, 65+ years. Enrolment: 29.
Status: Ongoing, recruiting. Start date (EU): 2021-05-31. Decision date: 2024-02-14. Results received: No. Last updated: 2026-07-28.
Decision dates by country: FR: 2024-02-19, IT: 2024-02-14, ES: 2024-02-15

Condition(s): Indolent Non-Hodgkin's Lymphoma (Follicular Lymphoma; Marginal Zone Lymphoma)
Product: LENALIDOMIDE, LENALIDOMIDE, EO2463, LENALIDOMIDE, LENALIDOMIDE, RITUXIMAB, RITUXIMAB

Primary endpoint: The primary endpoints of the phase 1 part of the trial are to define the recommended phase 2 dose (RP2D) for EO2463 monotherapy by applying a 3-by-3 trial design and defined acceptability levels for safety concern events (Cohort 1), and to confirm the safety of EO2463 at the monotherapy RP2D in combination with lenalidomide (EL; Cohort 4), rituximab (ER; Cohort 2), and lenalidomide/rituximab (ER^2; Cohorts 1 and 4)., The primary endpoint of the phase 2 part of the trial is to estimate the ORR according to the Lugano Classification, during EO2463 monotherapy (Cohort 1 weeks 1-6, Cohort 2 until (confirmed) disease progression, and Cohort 3 weeks 1-6), among patients evaluable for efficacy (i.e. patients having at least one tumor assessment post treatment start during EO2463 monotherapy)., An additional primary endpoint for the phase 2 part of the trial is to estimate the complete remission (CR)-rate according to the Lugano Classification 2014 during therapy with the combination of EO2463/lenalidomide/rituximab (ER) among patients evaluable for efficacy (i.e. patients having at least on tumor assessment post treatment start during combination therapy with ER).
Endpoint(s): Incidences of adverse events (AEs), treatment-emergent AEs (TEAEs), serious AEs (SAEs), deaths, treatment discontinuations/delays, and laboratory abnormalities using the NCI-CTCAE v5.0 grading system. For EO2463 administered as monotherapy, and in combination with lenalidomide, rituximab, and lenalidomide/rituximab., Level of changes (depletion/expansion), including durations, of B and T cells, and immunoglobulins, as measured in peripheral blood (FACS) and serum (electrophoresis or equivalent method), respectively., % of patients with shown immunogenicity (expansion of specific T cells comparing samples taken at baseline versus on treatment in an individual patient determining if the patient has a positive response to the immunization, or not) in relation to the peptides that compose EO2463 by IFN-γ, ELISpot, and by intracellular cytokines staining, and multimers staining assays. Cross reactivities with the human B cell antigens CD20, CD22, CD37, and BAFF-receptor will also be evaluated by the same methods, ORR and DOR as described by the Lugano Classification 2014, and by the Lymphoma Response to Immunomodulatory Therapy Criteria (LyRIC) 2016 by trial cohort., TTT, PFS and OS, as defined in the protocol

Source: https://euclinicaltrials.eu/ctis-public/view/2023-509254-58-00